EU clinical trial 2023-503771-13-00: A Randomized, Double-Blind, Placebo-Controlled Study to Evaluate the Efficacy and Safety of SPR001 (Tildacerfont) in Reducing Supraphysiologic Glucocorticoid Use in Adult Subjects with Classic Congenital Adrenal Hyperplasia
Protocol code: SPR001-204
Sponsor: Spruce Biosciences Inc. (Pharmaceutical company). Phase: Therapeutic exploratory (Phase II). Countries: Sweden (ended), Netherlands (ended), Denmark (ended), Romania (ended), Ireland (ended), Latvia (ended), Estonia (ended), Germany (ended), Spain (ended), Italy (ended), Lithuania (ended), Poland (ended).
Therapeutic area(s): Phenomena and Processes [G] - Genetic Phenomena [G05]
Gender: Female, Male. Age: 18-64 years, 65+ years. Enrolment: 44.
Status: Ended. Start date (EU): 2021-01-28. End date (EU): 2024-12-12. End date: 2025-01-31. Decision date: 2023-04-25. Results received: Yes. Last updated: 2024-12-18.
Decision dates by country: DK: 2023-04-25, IE: 2023-05-16, NL: 2023-05-01, LV: 2023-05-17, RO: 2023-05-09, IT: 2023-05-15, SE: 2023-04-26, EE: 2023-05-01, LT: 2023-05-26, ES: 2023-04-25, DE: 2023-05-02, PL: 2023-06-06

Condition(s): Classic Congenital Adrenal Hyperplasia
Product: same as IMP (Tildacerfont) minus the active substance, PREDNISOLONE, Tildacerfont, Prednisolon 1 mg JENAPHARM®, Hydrocortisone

Primary endpoint: Absolute change from baseline in glucocorticoid dose in hydrocortisone equivalent(s) at Week 24
Endpoint(s): 1. 1. Proportion of subjects with baseline GC dose ≤ 35mg HCe who achieve GC dose ≤11 mg/m2/day in HCe and A4 ≤ 1.2x baseline or ≤ ULN at Week 24, 2. Proportion of subjects with GC dose ≤11 mg/m2/day in HCe and A4 ≤ 1.2x baseline or A4 ≤ ULN at Week 24, 3. Proportion of subjects with improvement in at least one cardiovascular risk factor at Week 24.

Source: https://euclinicaltrials.eu/ctis-public/view/2023-503771-13-00